EU clinical trial 2023-509457-31-00: Study of Pembrolizumab combined with Ataluren in Patients with metastatic pMMR and dMMR colorectal cancer adenocarcinomas or metastatic dMMR endometrial carcinoma: the ATAPEMBRO study
Sponsor: Amsterdam UMC (Hospital/Clinic/Other health care facility). Phase: Phase I and Phase II (Integrated)- Other. Countries: Netherlands (ended).
Therapeutic area(s): Diseases [C] - Neoplasms [C04]
Gender: Female, Male. Age: 18-64 years, 65+ years. Enrolment: 47.
Status: Ended. Start date (EU): 2019-09-01. End date (EU): 2025-12-01. Decision date: 2024-05-13. Results received: No. Last updated: 2024-05-13.

Condition(s): metastatic colon cancer, advanced cancer of the colon

Source: https://euclinicaltrials.eu/ctis-public/view/2023-509457-31-00